EU clinical trial 2024-511511-25-00: Durvalumab (MEDI4736 ) plus tremelimumab in resectable, locally advanced squamous cell carcinoma of the oral cavity: a window of opportunity study
Protocol code: ESR-16-12192
Sponsor: UZ Leuven (Hospital/Clinic/Other health care facility). Phase: Phase I and Phase II (Integrated)- Other. Countries: Belgium (ended).
Therapeutic area(s): Diseases [C] - Neoplasms [C04]
Gender: Female, Male. Age: 18-64 years, 65+ years. Enrolment: 21.
Status: Ended. Start date (EU): 2018-10-12. End date (EU): 2026-03-25. Decision date: 2024-12-05. Results received: No. Last updated: 2024-12-05.

Condition(s): Resectable, locally advanced squamous cell carcinoma of the oral cavity.
Product: IMJUDO 20 mg/ml concentrate for solution for infusion., IMFINZI 50 mg/mL concentrate for solution for infusion., Cisplatin 1 mg/ml Concentrate for Solution for Infusion

Primary endpoint: CD8 infiltration in the tumor
Endpoint(s): Evaluation by 86Ga-CXCR-4 PET/MR; survival; safety.

Source: https://euclinicaltrials.eu/ctis-public/view/2024-511511-25-00